EU clinical trial 2022-502871-49-00: Evaluation of tolerance and pharmacokinetics profile of high dose favipiravir in healthy volunteers - FAVIDOSE
Protocol code: C18-47
Sponsor: Institut National De La Sante Et De La Recherche Medicale (Laboratory/Research/Testing facility). Phase: Human Pharmacology (Phase I)- Other. Countries: France (temporarily halted).
Therapeutic area(s): Diseases [C] - Virus Diseases [C02]
Gender: Female, Male. Age: 18-64 years, 65+ years. Enrolment: 39.
Status: Temporarily halted. Start date (EU): 2024-04-05. Decision date: 2023-04-25. Results received: No. Last updated: 2025-04-03.

Condition(s): healthy volunteers

Source: https://euclinicaltrials.eu/ctis-public/view/2022-502871-49-00